EU clinical trial 2025-524362-20-00: Open-label safety and efficacy trial of chlorhexidine and/or metronidazole pre-treatment followed by FB301 in women with bacterial vaginosis (BV)
Protocol code: FRB-004
Sponsor: Freya Biosciences ApS (Pharmaceutical company). Phase: Therapeutic exploratory (Phase II). Countries: Germany (authorised, recruiting).
Therapeutic area(s): Diseases [C] - Bacterial Infections and Mycoses [C01]
Gender: Female. Age: 18-64 years. Enrolment: 120.
Status: Authorised, recruiting. Start date (EU): 2026-03-23. Decision date: 2026-02-23. Results received: No. Last updated: 2026-07-18.

Condition(s): Bacterial vaginosis
Product: Arilin 500 mg Filmtabletten, Clorxil 5 mg/ml solución cutánea, FB301

Primary endpoint: The change in vaginal microbiome in terms of relative abundance of combined Lactobacillus crispatus and jensenii species measured by metagenomic sequencing of vaginal samples obtained from Visit 2 (Baseline) to Visit 3 (Week 3).
Endpoint(s): The change in vaginal microbiome in terms of relative abundance of combined Lactobacillus crispatus and jensenii species, measured by metagenomic sequencing in vaginal samples from Visit 2 (Baseline) to Visit 4 (Week 5), Visit 5 (Week 7), and Visit 6 (Week 10)., The change in vaginal microbiome in terms of relative abundance of combined vaginal Lactobacillus crispatus, jensenii, mulieris, gasseri and paragasseri measured by metagenomic sequencing in vaginal samples from Visit 2 (Baseline) to Visit 3 (Week 3), Visit 4 (Week 5), Visit 5 (Week 7), and Visit 6 (Week 10)., The change in vaginal microbiome in terms of relative abundance of Bifidobacterium spp. (previously Gardnerella spp.), Atopobium spp., and Fannyhessea spp. measured by metagenomic sequencing in vaginal samples from Visit 2 (Baseline) to Visit 3 (Week 3), Visit 4 (Week 5), Visit 5 (Week 7), and Visit 6 (Week 10)., Frequency and intensity of all AEs including frequency and grade of the AESIs. Clinically significant changes in clinical chemistry and hematology will also be evaluated., Proportion of participants with microbiological cure defined as Nugent Score of less than 4 at Visit 3 (Week 3), Visit 4 (Week 5), Visit 5 (Week 7), and Visit 6 (Week 10). Proportion of participants with clinical cure, defined as resolution of abnormal vaginal discharge, negative Whiff test, pH and presence of clue cells at less than 20% of the total epithelial cells on microscopic examination of the saline wet mount at Visit 3 (Week 3), Visit 5 (Week 7), and Visit 6 (Week 10).

Source: https://euclinicaltrials.eu/ctis-public/view/2025-524362-20-00